EU clinical trial 2024-514012-28-00: Effectiveness of ambroxol in children and adults with Gaucher disease 3: n-of-1 series
Protocol code: NL76160.018.21
Sponsor: Amsterdam UMC Stichting (Hospital/Clinic/Other health care facility). Phase: Therapeutic confirmatory (Phase III). Countries: Netherlands (ongoing, recruiting).
Therapeutic area(s): Diseases [C] - Nutritional and Metabolic Diseases [C18]
Gender: Female, Male. Age: 0-17 years, 18-64 years. Enrolment: 4.
Status: Ongoing, recruiting. Start date (EU): 2024-11-25. Decision date: 2024-11-25. Results received: No. Last updated: 2024-11-25.

Condition(s): Gaucher disease type 3
Product: lactose monohydrate, AMBROXOL

Primary endpoint: Change in cerebrospinal fluid (CSF) Lyso-GL1, from GD3 patients receiving ambroxol
Endpoint(s): Change in plasma Lyso-GL1, GL-1, chitotriosidase and Lyso-GM3, from GD3 patients receiving ambroxol, Change in CSF GL-1 and Lyso-GM3, from GD3 patients receiving ambroxol, Change in GCase activity in leukocytes, from GD3 patients receiving ambroxol, Effect of ambroxol on functional/developmental outcomes using the Goal Attainment Scaling (GAS) in GD3 patients, Effect of ambroxol on quality of life using the Pediatric Quality of Life Inventory (PedsQL) in GD3 patients, Effect of ambroxol on ataxia using the Scale for the Assessment and Rating of Ataxia (SARA) in GD3 patients, Effect of ambroxol on neuropsychological outcomes using the Attention Network Task (ANT) and/or Wechsler scale in GD3 patients, If epilepsy: effect of ambroxol on seizure control using the Unified Myoclonus Rating Scale (UMRS) and a seizure log book in GD3 patients

Source: https://euclinicaltrials.eu/ctis-public/view/2024-514012-28-00